EU clinical trial 2023-509234-19-00: KEYMAKER-U01 Substudy 01E: A Phase 2 Umbrella Study With Rolling Arms of Investigational Agents With or Without Chemotherapy in Combination With Pembrolizumab in Treatment of Participants With Newly Diagnosed Resectable Stages II-IIIB (N2) Non-small Cell Lung Cancer (NSCLC)
Protocol code: MK-3475-01E
Sponsor: Merck Sharp & Dohme LLC (Pharmaceutical company). Phase: Therapeutic exploratory (Phase II). Countries: Poland (ongoing, recruiting), Hungary (ongoing, recruiting), Italy (ongoing, recruiting), Spain (ongoing, recruiting), Germany (not authorised), Greece (ongoing, recruiting).
Therapeutic area(s): Diseases [C] - Neoplasms [C04]
Gender: Female, Male. Age: 18-64 years, 65+ years. Enrolment: 47.
Start date (EU): 2025-03-03. Decision date: 2024-09-16. Results received: No. Last updated: 2026-03-27.
Decision dates by country: ES: 2025-06-17, PL: 2024-09-16, HU: 2024-09-16, GR: 2025-06-17, IT: 2024-09-16

Condition(s): Participants With Newly Diagnosed Resectable Stages II-IIIB (N2) Non-small Cell Lung Cancer (NSCLC)
Product: KEYTRUDA 25 mg/mL concentrate for solution for infusion, CARBOPLATIN, GEMCITABINE, PACLITAXEL, FAMOTIDINE, MK-2870, PARACETAMOL, CISPLATIN, PEMETREXED

Primary endpoint: Pathological Complete Response (pCR), Percent Residual Viable Tumor (%RVT)
Endpoint(s): Percentage of Participants Who Report at Least 1 Adverse Event (AE), Percentage of Participants Who Discontinue Study Treatment Due to an AE, Event-free Survival (EFS), Overall Survival (OS), Distant Metastasis-Free Survival (DMFS), Objective Response Rate (ORR), Percentage of Participants Who Experience a Perioperative Complication, Mean Length of Length of Hospital Stay, Percentage of Participants Who Require Hospital Readmission after Discharge, Mean Length of Surgery, Percentage of Participants Who Require a Blood Transfusion

Source: https://euclinicaltrials.eu/ctis-public/view/2023-509234-19-00